EU clinical trial 2023-506381-32-00: A research study Looking into blood levels of the medicine NNC0519-0130 in the body of participants with normal or reduced kidney function
Protocol code: NN9541-4923
Sponsor: Novo Nordisk A/S (Pharmaceutical company). Phase: Human Pharmacology (Phase I)- First administration to humans. Countries: Germany (ended).
Therapeutic area(s): Diseases [C] - Nutritional and Metabolic Diseases [C18]
Gender: Female, Male. Age: 18-64 years, 65+ years. Enrolment: 36.
Status: Ended. Start date (EU): 2024-03-25. End date (EU): 2024-11-27. Decision date: 2024-03-04. Results received: No. Last updated: 2024-10-23.

Condition(s): Type 2 Diabetes Mellitus

Source: https://euclinicaltrials.eu/ctis-public/view/2023-506381-32-00